EU clinical trial 2024-514417-34-00: A Phase 3 Randomized, Open-label, Multicenter Study Assessing the Clinical Benefit of Isatuximab (SAR650984) in Combination with Bortezomib (Velcade®), Lenalidomide and Dexamethasone versus Bortezomib, Lenalidomide and Dexamethasone in Patients with Newly Diagnosed Multiple Myeloma Not Eligible for Transplant
Protocol code: EFC12522
Sponsor: Sanofi-Aventis Recherche & Developpement (Pharmaceutical company). Phase: Therapeutic confirmatory (Phase III). Countries: Denmark (ongoing, recruitment ended), France (ongoing, recruitment ended), Spain (ongoing, recruitment ended), Czechia (ongoing, recruitment ended), Portugal (ongoing, recruitment ended), Sweden (ongoing, recruitment ended), Germany (ongoing, recruitment ended), Italy (ongoing, recruitment ended), Poland (ongoing, recruitment ended), Greece (ongoing, recruitment ended), Lithuania (ongoing, recruitment ended).
Therapeutic area(s): Diseases [C] - Neoplasms [C04]
Gender: Female, Male. Age: 18-64 years, 65+ years. Enrolment: 308.
Status: Ongoing, recruitment ended. Start date (EU): 2017-12-14. Decision date: 2024-09-19. Results received: No. Last updated: 2026-07-06.
Decision dates by country: SE: 2024-09-20, IT: 2024-09-24, DE: 2024-09-20, ES: 2024-09-19, LT: 2024-10-03, GR: 2024-12-04, PL: 2024-09-30, CZ: 2024-09-20, PT: 2024-09-19, FR: 2024-09-20, DK: 2024-09-20

Condition(s): Cancer
Product: Isatuximab, Zelvina 10 mg hard capsules, VELCADE 3.5 mg powder for solution for injection, Zelvina 25 mg hard capsules, Revlimid 10 mg hard capsules, Dexamethasone 3.3 mg/ml solution for injection, Revlimid 25 mg hard capsules, Revlimid 20 mg hard capsules, Zelvina 20 mg hard capsules, Revlimid 20 mg hard capsules, Revlimid 5 mg hard capsules, Zelvina 5 mg hard capsules, Revlimid 25 mg hard capsules, Revlimid 15 mg hard capsules, DexaGalen® 8 mg injekt Injektionslösung, Dexamethason 4 mg JENAPHARM®, Revlimid 15 mg hard capsules, Zelvina 15 mg hard capsules, Revlimid 10 mg hard capsules, Revlimid 5 mg hard capsules

Primary endpoint: Progression free survival (PFS)
Endpoint(s): Complete response (CR), Minimal residual disease (MRD) negativity rate for participants with CR, Very good partial response (VGPR) or better rate, Overall survival (OS), Overall response rate (ORR), Time to progression (TTP), Duration of response (DOR), Time to first response (TT1R), Time to best response (TTBR), PFS on next line of therapy (PFS2), PFS in MRD negative participants, Sustained MRD negativity ≥12 months rate, Adverse Events, Assessment of PK parameter: Ctrough, Immunogenicity, Participants reported outcome (PRO): QLQ-C30, PRO: QLQ-MY20, PRO: EQ-5D-5L

Source: https://euclinicaltrials.eu/ctis-public/view/2024-514417-34-00